EU clinical trial 2025-521314-25-00: Phase 3 Randomized, Double-blind, Placebo-controlled Studies Assessing Ziftomenib in Combination with Either Standard of Care Nonintensive (Venetoclax+Azacitidine) or Intensive (7+3) Therapy in Patients with Untreated NPM1 Mutated or KMT2A Rearranged Acute Myeloid Leukemia
Protocol code: KO-MEN-017
Sponsor: Kura Oncology Inc. (Pharmaceutical company). Phase: Therapeutic confirmatory (Phase III). Countries: Belgium (ongoing, recruiting), Spain (ongoing, recruiting), Italy (authorised, recruiting), Czechia (authorised, recruiting), Hungary (authorised, recruiting), Poland (authorised, recruiting), France (ongoing, recruiting), Portugal (authorised, recruiting), Germany (authorised, recruiting), Greece (authorised, recruiting).
Therapeutic area(s): Diseases [C] - Neoplasms [C04]
Gender: Female, Male. Age: 18-64 years, 65+ years. Enrolment: 719.
Start date (EU): 2026-03-19. Decision date: 2026-02-20. Results received: No. Last updated: 2026-06-04.
Decision dates by country: CZ: 2026-02-24, FR: 2026-02-23, DE: 2026-02-27, HU: 2026-03-09, PT: 2026-02-26, ES: 2026-03-04, PL: 2026-03-07, IT: 2026-02-20, GR: 2026-02-24, BE: 2026-02-25

Condition(s): NPM1-m and KMT2A-r Acute Myeloid Leukemia
Product: Ziftomenib Placebo, CYTARABINE, VENETOCLAX, AZACITIDINE, VENETOCLAX, Daunoblastin® 20 mg Pulver zur Herstellung einer Infusions- oder Injektionslösung, Ziftomenib, VENETOCLAX, CYTARABINE

Primary endpoint: Nonintensive Therapy Study - Overall survival (OS) Intensive Therapy Study (7+3) - EFS, defined as the time from randomization to treatment failurea, hematologic relapse following CR, or death from any cause, whichever comes first
Endpoint(s): Nonintensive Therapy Study - CR rate per the ELN 2022 criteria per Investigator assessment - Percentage of patients achieving centrally defined BM MRD negativity - Rates of CR+CRh per ELN 2022 per Investigator assessment, Intensive Therapy Study (7+3) - Percentage of patients achieving CR per ELN 2022 criteria with centrally defined BM MRD negativity (CRMRD-) - Overall survival (OS)

Source: https://euclinicaltrials.eu/ctis-public/view/2025-521314-25-00